EU clinical trial 2025-523947-36-00: A Phase II, Multi-Center, Master Protocol to Evaluate the Efficacy and Safety of Volrustomig as Monotherapy or in Combination with Anti-cancer Agents in Participants with Advanced/Metastatic Solid Tumors (eVOLVE-02)
Protocol code: D798MC00002
Sponsor: AstraZeneca AB (Pharmaceutical company). Phase: Therapeutic exploratory (Phase II). Countries: Italy (ongoing, recruiting), Germany (ongoing, recruiting).
Therapeutic area(s): Diseases [C] - Neoplasms [C04]
Gender: Female, Male. Age: 18-64 years. Enrolment: 42.
Status: Ongoing, recruiting. Start date (EU): 2026-06-10. Decision date: 2026-05-05. Results received: No. Last updated: 2026-08-03.
Decision dates by country: IT: 2026-05-05, DE: 2026-05-06

Condition(s): Sub-study 5: Unresectable Pleural Mesothelioma (Volrustomig Monotherapy), Sub-study 4: Esophageal Squamous Cell Carcinoma (Volrustomig in Combination with Chemotherapy).
Product: INFLIXIMAB, MYCOPHENOLATE MOFETIL, volrustomig, FLUOROURACIL, PACLITAXEL, CISPLATIN

Primary endpoint: Objective response rate (ORR). Confirmed ORR is defined as the proportion of participants who have a confirmed CR or confirmed PR, as determined by Investigator per RECIST 1.1. Through study completion, an average of 4 years, The number of participants with adverse events/serious adverse events. Number of participants with adverse events and with serious adverse events including abnormal clinical observations, abnormal Electrocardiogram (ECG) parameters, abnormal laboratory assessments and abnormal vital signs that changed from baseline. Through study completion, an average of 4 years
Endpoint(s): Duration Of Response (DOR). DoR is defined as the time from the date of first documented confirmed response (which is subsequently confirmed) until date of documented progression per RECIST 1.1 as assessed by Investigator or ICR, or death due to any cause. Through study completion, an average of 4 years, Progression free survival (PFS). PFS is defined as the time from date of first dose of study intervention until progression per RECIST 1.1 as assessed by Investigator or ICR, or death due to any cause. Through study completion, an average of 4 years, Time to response (TTR). TTR is defined as the time from the date of the first dose of study intervention until the date of first documented objective response, which is subsequently confirmed per RECIST 1.1, as assessed by Investigator or ICR. Through study completion, an average of 4 years, Overall Survival (OS). OS is defined as the time from the date of first dose of study intervention until the date of death due to any cause. Through study completion, an average of 4 years, PK of volrustomig. Concentration of Volrustomig in serum. Through study completion, an average of 4 years, The immunogenicity of volrustomig. Incidence of ADAs against volrustomig in serum. Through study completion, an average of 4 years, Disease control rate (DCR). Disease control rate is defined as the proportion of participants with a BOR of confirmed CR, confirmed PR, or SD, as determined by Investigator per RECIST 1.1. Through study completion, an average of 4 years, PFS landmark. The landmark of PFS rates at 6, 9, and 12 months. Through study completion, an average of 4 years, OS landmark. The median OS and the landmark of OS rate at 12 months. Through study completion, an average of 4 years

Source: https://euclinicaltrials.eu/ctis-public/view/2025-523947-36-00